EU clinical trial 2024-519778-38-00: Cognitive effects of adjuntive Vortioxetine in early Schizophrenia
Sponsor: Fundacion Para La Gestion De La Investigacion En Salud De Sevilla (Laboratory/Research/Testing facility). Phase: Phase II and Phase III (Integrated). Countries: Spain (authorised, recruiting).
Therapeutic area(s): Psychiatry and Psychology [F] - Behavior and Behavior Mechanisms [F01]
Gender: Female, Male. Age: 18-64 years. Enrolment: 37.
Status: Authorised, recruiting. Start date (EU): 2024-12-02. Decision date: 2024-12-02. Results received: No. Last updated: 2025-03-06.

Condition(s): squizophrenia, Schizophrenia spectrum disorders
Product: QUETIAPINE, PIMOZIDE, VORTIOXETINE, CHLORPROMAZINE, RISPERIDONE, OLANZAPINE, ZIPRASIDONE, ARIPIPRAZOLE, THIORIDAZINE, HALOPERIDOL

Primary endpoint: Primary outcome measures: Cognitive functioning improvement assessed by the change in BACS App scores.

Source: https://euclinicaltrials.eu/ctis-public/view/2024-519778-38-00